EU clinical trial 2024-511658-28-01: Double blind, multicentric, randomized, placebo-controlled trial, evaluating the efficacy of 24-month of bezafibrate in primary sclerosing cholangitis with persistent cholestasis despite ursodeoxycholic acid therapy (BEZASCLER)
Protocol code: APHP180668
Sponsor: Assistance Publique Hopitaux De Paris (Hospital/Clinic/Other health care facility). Phase: Therapeutic confirmatory (Phase III). Countries: France (ongoing, recruitment ended).
Therapeutic area(s): Diseases [C] - Digestive System Diseases [C06]
Gender: Female, Male. Age: 18-64 years, 65+ years. Enrolment: 130.
Status: Ongoing, recruitment ended. Start date (EU): 2021-04-06. Decision date: 2024-09-10. Results received: No. Last updated: 2026-06-24.

Condition(s): primary sclerosing cholangitis
Product: BEFIZAL L.P. 400 mg, comprimé enrobé à libération prolongée, placebo of bezafibrate

Primary endpoint: Proportion of patients with serum Alkaline Phosphatase < 1.5 ULN and a reduction of at least 15% from baseline at M24 and normal serum bilirubin and no increase of liver stiffness at M24 compared to baseline (delta M24–M0 ≤ 0).
Endpoint(s): To compare between groups - Components of the primary composite outcome analyzed separately: Proportion of patients with: - serum Alkaline Phosphatase < 1.5 ULN at M24 and at least 15% of decrease from baseline at M24; - complete normalization of s-ALP at M24 (s-ALP ≤ 1.0 ULN at M24); - normal serum bilirubin; - no increase in liver stiffness at M24, To compare between groups - Safety endpoint: Percentage of patients with clinical (including increased IBD activity) or biological, To compare between groups: - Quality of life (QMCF questionnaire – Questionnaire de la maladie chronique du foie) and scores for pruritus (measured by VAS and 5D pruritus scale) and fatigue (measured by adapted PBC-40 questionnaire (M0, M12 and M24)), To compare between groups: Changes in Patient-Reported Outcomes (PRO) specific for PSC (45)., To compare between groups: - Changes in biochemical liver tests other than ALP, including total and conjugated bilirubin, GGT, AST, ALT, albumin, and INR,, To compare between group survival rate without liver transplantation or hepatic events (ascites, variceal bleeding, encephalopathy, acute cholangitis, cholangiocarcinoma, hepatocellular carcinoma or serum total bilirubin > 100 μmol/L for at least 3 months). PSC Prognostic scores including the MELD score, the Revised PSC Mayo Risk Score, the Hannover Score and the Amsterdam-Oxford prognostic model (M0, M12, M24)

Source: https://euclinicaltrials.eu/ctis-public/view/2024-511658-28-01